EU clinical trial 2024-520395-99-00: A Phase 1/2, open-label, multicenter, dose-escalation, and dose‑optimization study to evaluate the safety, tolerability, and activity of EIK1004 (IMP1707) as monotherapy in participants with advanced solid tumors.
Protocol code: EIK1004-001
Sponsor: Eikon Therapeutics Inc. (Pharmaceutical company). Phase: Phase I and Phase II (Integrated)- First administration to humans. Countries: Denmark (ongoing, recruiting), Spain (ongoing, recruiting), Portugal (authorised, recruiting), France (ongoing, recruiting).
Therapeutic area(s): Diseases [C] - Neoplasms [C04]
Gender: Female, Male. Age: 18-64 years, 65+ years. Enrolment: 42.
Start date (EU): 2025-08-12. Decision date: 2025-07-14. Results received: No. Last updated: 2026-06-05.
Decision dates by country: FR: 2025-07-31, PT: 2025-07-14, ES: 2025-07-16, DK: 2025-07-14

Condition(s): Advanced solid tumors
Product: EIK1004 20mg Tablets, EIK1004 5mg Tablets

Primary endpoint: • Dose-limiting toxicities (DLTs), • Adverse events (AEs)
Endpoint(s): • PK parameters derived from plasma concentration data of EIK1004 and/or metabolites (if applicable) following single oral dose, • PK parameters derived from plasma concentration data of EIK1004 and/or metabolites (if applicable) following multiple oral doses, • Objective Response (OR), • Disease Control (DC), • Duration of Response (DOR), • Time to response (TTR), • Percentage change from Baseline in sum of target lesions., • Clinical benefit (CB), • Time to CNS progression

Source: https://euclinicaltrials.eu/ctis-public/view/2024-520395-99-00